EU clinical trial 2024-514322-23-00: The impact of the intensity of ovarian stimulation on embryo quality in predicted suboptimal responders. A randomized controlled trial.
Protocol code: FSD-IEQ-2021-03
Sponsor: Santiago Dexeus Font Fundacio Privada (Laboratory/Research/Testing facility). Phase: Therapeutic use (Phase IV). Countries: Spain (ended).
Therapeutic area(s): Diseases [C] - Female Urogenital Diseases and Pregnancy Complications [C13]
Gender: Female. Age: 18-64 years. Enrolment: 110.
Status: Ended. Start date (EU): 2024-09-09. End date (EU): 2026-03-11. Decision date: 2024-09-09. Results received: No. Last updated: 2024-09-09.

Condition(s): infertility
Product: Ovaleap 900 IU/1.5 mL solution for injection, Ovaleap 450 IU/0.75 mL solution for injection, Decapeptyl diario 0,1 mg polvo y disolvente para solución inyectable, Ovitrelle 250 micrograms/0.5 mL solution for injection in pre-filled syringe, Utrogestan 200 mg cápsulas vaginales blandas, Omifin 50 mg comprimidos, Orgalutran 0.25 mg/0.5 mL solution for injection, Ovaleap 300 IU/0.5 mL solution for injection

Primary endpoint: The primary efficacy endpoint is the number of good-quality blastocysts (GQB), according to the Istanbul Consensus Criteria. The primary efficacy endpoint is related to the primary trial objective.
Endpoint(s): Time of pronuclei appearance, Time of pronuclei disappearance, The total number of embryos, Time of division from 2 to 8 cells, Time of compactation, Time of morula, Time of cavitation, Time of full blastulation, Time of expanded blastocyst, Time of hatched blastocyst, Blastocyst formation rate, Cycle cancelation rate

Source: https://euclinicaltrials.eu/ctis-public/view/2024-514322-23-00